EU clinical trial 2024-517309-95-00: Prospective, randomised, placebo-controlled study of polyvalent intravenous immunoglobulins for the treatment of primary Sjögren's syndrome associated painful sensory neuropathies
Protocol code: 6621
Sponsor: Les Hopitaux Universitaires De Strasbourg (Hospital/Clinic/Other health care facility). Phase: Therapeutic confirmatory (Phase III). Countries: France (ended).
Therapeutic area(s): Diseases [C] - Nervous System Diseases [C10]; Diseases [C] - Immune System Diseases [C20]
Gender: Female, Male. Age: 18-64 years, 65+ years. Enrolment: 24.
Status: Ended. Start date (EU): 2019-06-19. End date (EU): 2025-04-10. Decision date: 2024-10-08. Results received: Yes. Last updated: 2024-10-08.

Condition(s): -Peripheral neuropathy clinically defined: *Pure sensitive (lymph node disease) or sensorimotor neuropathies; *Proved EMG, -Primary Sjögren's syndrome defined as per the European and American criteria
Product: Privigen 100 mg/ml solution for infusion, SODIUM CHLORIDE SOLUTION 0.9%

Primary endpoint: Improvement of at least 20% over placebo in one of the following 2 scales, 3 weeks after the last treatment course (week 11): - Objective neurological criterion using the R-ODS scale (Rasch-built Overall Disability Scale) - Numerical Pain Scale (0 to 10)
Endpoint(s): 1) Primary Sjögren's Syndrome Criteria o Quality of life scale (SF 36) o HAD depression score o Numerical Fatigue Scale : score between 0 and 10 o A fatigue scale (EMIF) : o Numerical Dry mouth Scale : score between 0 and 10 o Numerical Dry eye Scale : score between 0 and 10 o Flow of saliva (non stimulated o ESSPRI (Eular Sjogren's Syndrome Patient Reported Index) o ESSDAI (Eular Sjögren Syndrome Disease Activity index), 2) Neurological criteria o Overall Neuropathy Limitations Scale (ONLS), 3) Adverse reactions rate

Source: https://euclinicaltrials.eu/ctis-public/view/2024-517309-95-00